EU clinical trial 2024-517644-62-00: Phase 1, Randomized, Double-blind, Placebo-Controlled, First-in-Human Single Ascending Dose Study in Healthy Participants to Assess the Safety, Tolerability, and Pharmacokinetics of JNJ-95597528 and a Proof of Mechanism Study in Participants with Mild to Moderate Asthma
Protocol code: 95597528EDI1001
Sponsor: Janssen Cilag International (Pharmaceutical company). Phase: Human Pharmacology (Phase I)- First administration to humans. Countries: Germany (ongoing, recruitment ended), Belgium (ongoing, recruitment ended).
Therapeutic area(s): Diseases [C] - Respiratory Tract Diseases [C08]
Gender: Female, Male. Age: 18-64 years. Enrolment: 46.
Status: Ongoing, recruitment ended. Start date (EU): 2025-06-30. Decision date: 2025-06-03. Results received: No. Last updated: 2026-04-23.
Decision dates by country: DE: 2025-06-06, BE: 2025-06-03

Condition(s): Mild to Moderate Asthma

Source: https://euclinicaltrials.eu/ctis-public/view/2024-517644-62-00